EU clinical trial 2024-518863-36-00: A clinical study of the V540C vaccine in healthy adults (V540C-003)
Protocol code: V540C-003
Sponsor: Merck Sharp & Dohme LLC (Pharmaceutical company). Phase: Human Pharmacology (Phase I)- First administration to humans. Countries: Belgium (ongoing, recruiting).
Therapeutic area(s): Diseases [C] - Virus Diseases [C02]
Gender: Female, Male. Age: 18-64 years. Enrolment: 54.
Status: Ongoing, recruiting. Start date (EU): 2025-05-27. Decision date: 2025-01-08. Results received: No. Last updated: 2026-05-29.

Condition(s): Human Papilloma virus

Source: https://euclinicaltrials.eu/ctis-public/view/2024-518863-36-00